EU clinical trial 2023-504031-41-00: CAMBRIA-2: A Phase III, Open-Label, Randomised Study to Assess the Efficacy and Safety of Camizestrant (AZD9833, a Next Generation, Oral Selective Estrogen Receptor Degrader) vs Standard Endocrine Therapy (Aromatase Inhibitor or Tamoxifen) as Adjuvant Treatment for Patients With ER+/HER2- Early Breast Cancer and an Intermediate-High or High Risk of Recurrence Who Have Completed Definitive Locoregional Treatment and Have No Evidence of Disease
Protocol code: D8535C00001
Sponsor: AstraZeneca AB (Pharmaceutical company). Phase: Therapeutic confirmatory (Phase III). Countries: Belgium (ongoing, recruitment ended), Spain (ongoing, recruitment ended), Hungary (ongoing, recruitment ended), Poland (ongoing, recruitment ended), Czechia (ongoing, recruitment ended), Portugal (ongoing, recruitment ended), France (ongoing, recruitment ended), Italy (ongoing, recruitment ended), Greece (ongoing, recruitment ended), Bulgaria (ongoing, recruitment ended), Croatia (ongoing, recruitment ended), Ireland (ongoing, recruitment ended), Romania (ongoing, recruitment ended), Germany (ongoing, recruitment ended), Estonia (ongoing, recruitment ended), Austria (ongoing, recruitment ended).
Therapeutic area(s): Diseases [C] - Neoplasms [C04]
Gender: Female, Male. Age: 18-64 years, 65+ years. Enrolment: 2049.
Status: Ongoing, recruitment ended. Start date (EU): 2024-03-25. Decision date: 2024-01-10. Results received: No. Last updated: 2026-05-13.
Decision dates by country: AT: 2024-01-15, BE: 2024-01-11, BG: 2024-01-15, HR: 2024-01-12, CZ: 2024-01-12, EE: 2024-01-11, FR: 2024-01-10, GR: 2024-01-15, HU: 2024-01-12, IE: 2024-01-12, IT: 2024-01-12, RO: 2024-01-15, ES: 2024-01-15, PL: 2024-01-12, PT: 2025-05-19, DE: 2024-01-10

Condition(s): ER+/HER2- Early Breast Cancer
Product: LETROZOLE, Arimidex® 1 mg Filmtabletten, Camizestrant, ABEMACICLIB, GOSERELIN, TRIPTORELIN, LEUPRORELIN ACETATE, Nolvadex® 20 mg Filmtabletten, EXEMESTANE

Primary endpoint: Primary efficacy IBCFS (invasive breast cancer free-survival) as defined by STEEP 2.0 criteria
Endpoint(s): Secondary efficacy IDFS(invasive disease-free survival) as defined by STEEP 2.0 criteria DRFS(distant relapse-free survival) as defined by STEEP 2.0 criteria OS(overall survival), Secondary safety Safety endpoints including: • TEAEs(treatment-emergent adverse event), SAEs(serious adverse event) • Clinical laboratory tests and vital signs, Secondary COAs(clinical outcome assessment): Proportion of time on study treatment with high side-effect burden as measured by the PGI-TT, Secondary COAs (clinical outcome assessment) Change from baseline and TTD(time to deterioration ) of health-related QoL(quality of life) as measured by the 2 global QoL (quality of life) items from the EORTC IL-311 (European Organisation for Research and Treatment of Cancer), Secondary PK(pharmacokinetic(s) Plasma concentrations of camizestrant pre-dose (Ctrough)( trough concentration)

Source: https://euclinicaltrials.eu/ctis-public/view/2023-504031-41-00